EU clinical trial 2024-517621-54-00: ALBAN : An open label, randomized, phase III trial, evaluating efficacy of Atezolizumab in addition to one year BCG (Bacillus CaLmette-Guerin) bladder instillation in BCG-naive patients with high-risk non-muscle invasive Bladder cANcer
Protocol code: UC-0160/1717
Sponsor: Unicancer (Hospital/Clinic/Other health care facility). Phase: Therapeutic confirmatory (Phase III). Countries: Spain (authorised, recruitment pending), France (authorised, recruitment pending), Belgium (authorised, recruitment pending).
Therapeutic area(s): Diseases [C] - Neoplasms [C04]
Gender: Female, Male. Age: 0-17 years, 18-64 years. Enrolment: 517.
Status: Authorised, recruitment pending. Decision date: 2024-10-30. Results received: No. Last updated: 2024-12-31.
Decision dates by country: BE: 2024-11-04, FR: 2024-12-31, ES: 2024-10-30

Condition(s): High-risk non-muscle invasive bladder cancer (NMIBC) after transurethral resection of the bladder (TURBT) and pathological assessment.
Product: Tecentriq 1 200 mg concentrate for solution for infusion

Primary endpoint: Event-free survival defined as the time from randomization to the time of first EFS event.
Endpoint(s): High-grade recurrence-free survival is defined by reappearance of high risk disease (high grade, T1 or CIS), Progression-free survival is defined as the time from randomization to the date of progression or death. Progression is defined as increase of stage from Ta to T1 or from CIS to T1; progression to MIBC (T≥ 2) or to lymph node N+ or to distant disease M+, Disease-specific survival defined as the time from randomization to the date of death from bladder cancer;, Overall Survival, defined as the time from randomization to the date of death from any cause, Disease worsening, defined as cystectomy or indicative change in therapy, including systemic chemotherapy or radiation therapy. The date of diagnosis (cystoscopy or CT) leading to cystectomy or chemotherapy/radiotherapy will be considered as the time of disease worsening, Complete response will be measured among patients with CIS disease with or without papillary tumor at diagnosis, Week 12, Week 51, and 2 years after randomization. It will be defined by normal cystoscopy and normal cytology., Duration of response (DOR) is defined as the interval from response initiation (when either complete or partial response is first determined) to progression or death, whichever occurs first., Frequency, nature, and severity of adverse events graded according to NCI CTCAE v5.0 and immune-related event (irAE), Quality of life will be measured using EORTC QLQ-C30 assessed at baseline and then every 12 weeks for year 1-2 then every 24 weeks for year 3-5, Status of tumor immune-related biomarkers in archival and /or freshly obtained tissues;, Status of exploratory biomarkers in urine, plasma, whole blood collected before and during treatment with atezolizumab or at recurrence and association with outcome

Source: https://euclinicaltrials.eu/ctis-public/view/2024-517621-54-00